EU clinical trial 2025-524709-34-00: MitOxyVit: Mitochondrial network modulation approach using hyperbaric oxygen (HBO) therapy and NNbUVB for treating vitiligo
Protocol code: 25-AOI-MED-02
Sponsor: Centre Hospitalier Universitaire De Nice (Hospital/Clinic/Other health care facility). Phase: Therapeutic exploratory (Phase II). Countries: France (authorised, recruitment pending).
Therapeutic area(s): Diseases [C] - Skin and Connective Tissue Diseases [C17]
Gender: Female, Male. Age: 18-64 years, 65+ years. Enrolment: 5.
Status: Authorised, recruitment pending. Decision date: 2026-03-24. Results received: No. Last updated: 2026-05-28.
Decision dates by country: FR: 2026-06-12

Condition(s): Vitiligo
Product: OXYGENE MEDICINAL LINDE HEALTHCARE 200 bar, gaz pour inhalation, en bouteille

Primary endpoint: Mean percentage of change from baseline (CFB) of VASI at week 24.
Endpoint(s): 1. Mean percentage of change from baseline (CFB) of VASI at week 12, 2. VSAS between baseline and each visit, 3. VNS between baseline and each visit, 4. Frequency and severity of adverse events collection

Source: https://euclinicaltrials.eu/ctis-public/view/2025-524709-34-00